EU clinical trial 2024-515853-48-00: A study to compare pharmacokinetics, efficacy, safety, and immunogenicity of MB12 (proposed pembrolizumab biosimilar) to Keytruda® in non-small cell lung cancer
Protocol code: MB12-C-02-24
Sponsor: Mabxience Research S.L. (Pharmaceutical company). Phase: Therapeutic confirmatory (Phase III). Countries: Portugal (authorised, recruitment pending), Slovakia (authorised, recruiting), Croatia (ended), Romania (authorised, recruiting), Spain (authorised, recruiting), Germany (ended), Greece (authorised, recruiting), Poland (authorised, recruiting), Italy (authorised, recruiting).
Therapeutic area(s): Diseases [C] - Neoplasms [C04]
Gender: Female, Male. Age: 18-64 years, 65+ years. Enrolment: 111.
Start date (EU): 2025-09-05. Decision date: 2025-03-25. Results received: No. Last updated: 2026-05-11.
Decision dates by country: HR: 2025-03-31, DE: 2025-03-25, RO: 2025-03-31, IT: 2025-03-27, SK: 2025-03-31, ES: 2025-03-27, GR: 2025-03-28, PT: 2025-03-25, PL: 2025-03-27

Condition(s): advanced/metastatic non-squamous non-small cell lung cancer (NSCLC)

Source: https://euclinicaltrials.eu/ctis-public/view/2024-515853-48-00